EU clinical trial 2024-511007-41-00: Phase 1b/2a safety and tolerability study of bemcentinib with pembrolizumab/carboplatin/pemetrexed in subjects with untreated advanced or metastatic non-squamous non-small cell lung cancer (NSCLC) without/with a STK11 mutation.
Protocol code: BGBC016
Sponsor: Bergenbio ASA (Pharmaceutical company). Phase: Phase I and Phase II (Integrated)- Other. Countries: France (ended), Italy (ended), Greece (ended), Poland (ended), Spain (ended), Hungary (ended).
Therapeutic area(s): Diseases [C] - Neoplasms [C04]
Gender: Female, Male. Age: 18-64 years, 65+ years. Enrolment: 52.
Status: Ended. Start date (EU): 2023-10-03. End date (EU): 2025-02-25. End date: 2025-04-03. Decision date: 2024-08-06. Results received: Yes. Last updated: 2025-05-08.
Decision dates by country: FR: 2024-08-13, GR: 2024-08-22, HU: 2024-08-06, IT: 2024-08-13, ES: 2024-08-06, PL: 2024-09-20

Condition(s): Untreated advanced or metastatic non-squamous non-small cell lung cancer (NSCLC) without/with a STK11 mutation.
Product: Bemcentinib 75 mg, Bemcentinib 50 mg, PEMETREXED, PEMBROLIZUMAB, Bemcentinib 100 mg, CARBOPLATIN, PEMETREXED

Primary endpoint: Phase 1b: The incidence of dose limiting toxicities (DLTs) during a 21-day assessment period in treatment cycle 1 (i.e., the first 21 days from cycle 1 day 1 (C1D1) for each subject) Phase 2a: Objective response rate (ORR - complete response and partial response per RECIST 1.1) at 6 and 12 months.
Endpoint(s): Phase 1b: - ORR (complete response and partial response per RECIST 1.1) Phase 2a: - The frequency and percentage of AEs; assessment of safety laboratory parameters, vital signs, and ECGs per CTCAE, Phase 1b: - Disease control rate (DCR) (complete response, partial response, and stable disease per RECIST 1.1) Phase 2a: - DCR (complete response, partial response, and stable disease), Phase 1b: - Duration of response (DOR) Time of first response to progressive disease as assessed per RECIST 1.1) Phase 2a: - DOR, Phase 1b: - Overall survival Phase 2a: - Progression free survival (PFS), Phase 2a: - Time to progression (TTP), Phase 2a: - Overall survival, Phase 2a: - PK exposure (Cmax, AUC, and t½)

Source: https://euclinicaltrials.eu/ctis-public/view/2024-511007-41-00